EU clinical trial 2023-510021-16-00: A Phase 1 Multicenter, Open Label, First-in-Human Dose Escalation Study of AFM28, a Bispecific ICE® that Targets CD123 and CD16A, in patients with CD123-Positive Relapsed/Refractory Acute Myeloid Leukemia
Protocol code: AFM28-101
Sponsor: Affimed GmbH (Pharmaceutical company). Phase: Human Pharmacology (Phase I)- First administration to humans. Countries: France (ended), Spain (ended).
Therapeutic area(s): Diseases [C] - Neoplasms [C04]
Gender: Female, Male. Age: 18-64 years, 65+ years. Enrolment: 60.
Status: Ended. Start date (EU): 2023-03-08. End date (EU): 2025-06-11. Decision date: 2024-10-08. Results received: No. Last updated: 2025-04-16.
Decision dates by country: ES: 2024-10-08, FR: 2024-10-11

Condition(s): Refractory/relapsed (R/R) CD123-positive acute myeloid leukemia (AML)

Source: https://euclinicaltrials.eu/ctis-public/view/2023-510021-16-00